EU clinical trial 2024-515010-40-00: AcTIVE - ACid tranexamic or Terlipressin for Initial emergency treatment of mild to seVere hEmoptysis: a randomized Trial
Protocol code: APHP200043
Sponsor: Assistance Publique Hopitaux De Paris (Hospital/Clinic/Other health care facility). Phase: Therapeutic confirmatory (Phase III). Countries: France (ended).
Therapeutic area(s): Diseases [C] - Respiratory Tract Diseases [C08]
Gender: Female, Male. Age: 18-64 years, 65+ years. Enrolment: 315.
Status: Ended. Start date (EU): 2022-03-28. End date (EU): 2026-01-28. Decision date: 2024-10-09. Results received: No. Last updated: 2025-04-04.

Condition(s): Hemoptysis, whatever the cause, with the exception of cystic fibrosis
Product: NaCl 0.9%, TRANEXAMIC ACID, TERLIPRESSIN

Primary endpoint: The primary end-point is defined as the proportion of patients with complete or partial resolution of hemoptysis without the use of any interventional procedure. A complete resolution of hemoptysis is defined by absence of recurrence within 3 days; partial resolution is defined as hemoptysis recurrence < 50 mL within the first 3 days.
Endpoint(s): Rate of complete resolution of hemoptysis within 3 days, as previously defined, Rate of partial resolution of hemoptysis defined as recurrence < 50 mL within 3 days, as previously defined, Proportion of patients with total volume of hemoptysis < 200 mL within 3 days, Rate of patients who need an endovascular treatment (bronchial arterial endovascular embolization) within 3 days, Time between hospital admission and endovascular treatment, In-hospital mortality, 30-day rate of patients with hemoptysis recurrence, 30-day mortality, Rate of specific adverse events : acute myocardial ischemia, symptomatic venous thromboembolism, hyponatremia (<130 mmol/L), bronchospasm (defined by the need of short-acting bronchodilatator). Anticipated candidate's variables for the assessment of the hemoptysis recurrence riskinclude the followings: age, sex, baseline expectorated blood volume, cause of hemoptysis, previous hemoptysis, coagulation disorders, need in mechanical ventilation, treatment group.

Source: https://euclinicaltrials.eu/ctis-public/view/2024-515010-40-00